EU clinical trial 2024-517132-22-00: Multicenter, prospective, double-blind, randomized, three-armed, placebo-controlled study of long-term therapeutic transfer of encapsulated stool microbiome for the treatment of active ulcerative colitis
Protocol code: FRESCO
Sponsor: Friedrich-Schiller-Universitaet Jena (Educational Institution). Phase: Therapeutic confirmatory (Phase III). Countries: Germany (ongoing, recruitment ended).
Therapeutic area(s): Diseases [C] - Digestive System Diseases [C06]
Gender: Female, Male. Age: 18-64 years, 65+ years. Enrolment: 129.
Status: Ongoing, recruitment ended. Start date (EU): 2023-01-26. Decision date: 2024-11-08. Results received: No. Last updated: 2026-01-12.

Condition(s): active ulcerative colitis
Product: Fecal Microbiome Filtrate (FMF), VANCOMYCIN, Placebo, unauthorised capsule, hard for oral use, METRONIDAZOLE, Fecal microbiome (FM)

Primary endpoint: clinical remission at week 12 post transfer defined by Mayo score ≤ 2 and any subcore ≤ 1, missing values to week 12 are considered as no remission
Endpoint(s): - steroid-free clinical remission, - Mayo score, - endoscopic remission, - clinical response, - mucosal infammation (fecal calprotectin), - histological mucosal inflammation (Nancy index), - quality of life, - microbiome and virome analysis, - safety

Source: https://euclinicaltrials.eu/ctis-public/view/2024-517132-22-00